EU clinical trial 2023-505088-35-00: A Phase I/II, Open-Label, Dose-Escalation and Expansion Study of Entrectinib (RXDX -101) in Pediatrics with Locally Advanced or Metastatic Solid or Primary CNS Tumors and/or who have no Satisfactory Treatment Options
Protocol code: CO40778
Sponsor: F. Hoffmann-La Roche AG (Pharmaceutical company). Phase: Phase I and Phase II (Integrated)- Other. Countries: Germany (ongoing, recruitment ended), Italy (ongoing, recruitment ended), France (ongoing, recruitment ended), Spain (ongoing, recruitment ended).
Therapeutic area(s): Diseases [C] - Neoplasms [C04]
Gender: Female, Male. Age: 0-17 years. Enrolment: 25.
Status: Ongoing, recruitment ended. Start date (EU): 2019-12-12. Decision date: 2024-06-19. Results received: No. Last updated: 2025-07-21.
Decision dates by country: IT: 2024-06-24, ES: 2024-06-21, FR: 2024-06-24, DE: 2024-06-19

Condition(s): Pediatric Solid tumors and primary central nervous system (CNS) tumors
Product: Rozlytrek, Rozlytrek, Rozlytrek

Primary endpoint: 1. Dose limiting toxicity DLT during the first cycle (28 days) in pediatric patients with relapsed or refractory solid tumors using the F1 formulation (and subsequently using F06, minitablets). The RP2D will be determined from DLT derived from clinical and laboratory observations in the first treatment cycle according to the NCI CTCAE v4.03 that is related to entrectinib), 2. Objective response rate as assessed by the BICR will be evaluated in the efficacy evaluable population from the Phase II dose expansion cohorts (Cohort B and D)
Endpoint(s): 1. Incidence and severity of adverse events, laboratory and electrocardiogram (ECG) abnormalities, 2. Maximal plasma concentration (Cmax) of entrectinib (F1, F06 given intact, F06 administered via feeding tube, and minitablets), 3. Time of maximal plasma concentration (Tmax) of entrectinib (F1, F06 given intact, F06 administered via feeding tube, and minitablets), 4. Area under the plasma concentration vs. time curve (AUC) of entrectinib (F1, F06 given intact, F06 administered via feeding tube, and minitablets), 5. ORR in the efficacy evaluable and safety evaluable populations, 6. DOR and TTR as assessed by BICR and the investigator in the efficacy evaluable and safety evaluable populations:, 7. ORR, TTR, DOR in the efficacy evaluable and safety evaluable populations as assessed by BICR and the investigator with use of RECIST v1.1, RANO, and the Curie scale, as applicable, 8. CBR and PFS in the efficacy evaluable and safety evaluable populations as assessed by BICR and investigator with use of RECIST v1.1, RANO, and the Curie scale, as applicable, 9. OS in the efficacy evaluable and safety evaluable populations, 10. Assessment of growth (weight, height), puberty (Tanner), neurological function and neurocognitive function of patients on treatment, 11. Acceptability and palatability assessment for F06 capsules and minitablets formulation

Source: https://euclinicaltrials.eu/ctis-public/view/2023-505088-35-00